EU clinical trial 2024-515101-26-00: Randomized, open-label, Phase 3 study of SAR408701 versus docetaxel in previously treated, metastatic nonsquamous, non-small-cell lung cancer patients with CEACAM5-positive tumors
Protocol code: EFC15858
Sponsor: Sanofi-Aventis Recherche & Developpement (Pharmaceutical company). Phase: Therapeutic confirmatory (Phase III). Countries: France (ended).
Therapeutic area(s): Diseases [C] - Neoplasms [C04]
Gender: Female, Male. Age: 18-64 years, 65+ years. Enrolment: 1.
Status: Ended. Start date (EU): 2020-08-21. End date (EU): 2024-11-14. End date: 2026-04-16. Decision date: 2024-11-05. Results received: No. Last updated: 2024-11-05.

Condition(s): Non-small cell lung cancer metastatic

Primary endpoint: Progression free survival (PFS), Overall Survival (OS)
Endpoint(s): Objective response rate (ORR), Health related quality of life (HRQOL) - disease related symptoms, Health related quality of life (HRQOL) - physical function, Health related quality of life (HRQOL) - role function, Number of participants with treatment emergent adverse events (TEAEs) and serious adverse events (SAEs), Duration of response (DOR)

Source: https://euclinicaltrials.eu/ctis-public/view/2024-515101-26-00